EU clinical trial 2023-505658-17-00: A Phase 1/2 Study of V940 Plus Pembrolizumab With or Without Enfortumab Vedotin in Muscle-Invasive Urothelial Carcinoma (MIUC) (INTerpath-005)
Protocol code: V940-005
Sponsor: Merck Sharp & Dohme LLC (Pharmaceutical company). Phase: Therapeutic exploratory (Phase II). Countries: France (ongoing, recruitment ended), Poland (ongoing, recruitment ended), Germany (ongoing, recruitment ended), Spain (ongoing, recruitment ended), Italy (ongoing, recruitment ended), Sweden (ongoing, recruitment ended).
Therapeutic area(s): Diseases [C] - Neoplasms [C04]
Gender: Female, Male. Age: 18-64 years, 65+ years. Enrolment: 90.
Status: Ongoing, recruitment ended. Start date (EU): 2024-04-16. Decision date: 2024-03-28. Results received: No. Last updated: 2026-06-09.
Decision dates by country: PL: 2024-04-02, SE: 2024-04-03, FR: 2024-03-28, IT: 2024-04-03, ES: 2024-04-01, DE: 2024-04-03

Condition(s): Muscle-invasive Urothelial Carcinoma
Product: ENFORTUMAB VEDOTIN, KEYTRUDA 25 mg/mL concentrate for solution for infusion, mRNA-4157, Placebo to V940

Primary endpoint: Adjuvant Cohort: Disease-Free Survival (DFS), Perioperative Cohort: Number of Participants Who Experience an Adverse Event (AE), Perioperative Cohort: Number of Participants Who Discontinue Study Treatment Due to AE
Endpoint(s): Adjuvant Cohort: Overall-Survival (OS), Adjuvant Cohort: Distant Metastasis-Free Survival (DMFS), Adjuvant Cohort: Number of Participants Who Experience an AE, Adjuvant Cohort: Number of Participants Who Discontinue Study Treatment Due to an AE, Perioperative Cohort: Pathologic Complete Response (pCR) Rate, Perioperative Cohort: Pathologic Downstaging (pDS) Rate

Source: https://euclinicaltrials.eu/ctis-public/view/2023-505658-17-00